EU clinical trial 2024-513106-62-00: An open label, balanced, randomized, two-treatment, two-period, two-sequence, single dose crossover bioequivalence study comparing Lamotrigine Dispersible Tablets BP 100 mg, manufactured by Sun Pharmaceutical Industries Limited, India with Lamictal (Lamotrigine) Dispersible Tablets 100 mg, Manufactured by: Delpharm Poznaÿ – Poland & Registered and Imported by: GlaxoSmithKline Brasil Ltda, in healthy adult, human subjects under fasting condition.
Protocol code: LAMOT-04-24
Sponsor: Sun Pharmaceutical Industries Limited (Pharmaceutical company). Phase: Human Pharmacology (Phase I)- Bioequivalence Study. Countries: Romania (ended).
Therapeutic area(s): Diseases [C] - Nervous System Diseases [C10]
Gender: Female, Male. Age: 18-64 years. Enrolment: 30.
Status: Ended. Start date (EU): 2024-12-16. End date (EU): 2025-02-14. Decision date: 2024-07-29. Results received: No. Last updated: 2024-07-29.

Condition(s): Bipolar disorder, Epilepsy

Source: https://euclinicaltrials.eu/ctis-public/view/2024-513106-62-00